EU clinical trial 2025-524397-42-00: A Phase 2/3 Study to Characterize and Evaluate the Efficacy, Safety, and Tolerability of hu14.18K322A Treatment Given in Combination with Chemotherapy in Participants with High-Risk Neuroblastoma
Protocol code: EPG-HU1418-201
Sponsor: Renaissance Pharma Limited (Pharmaceutical company). Phase: Phase II and Phase III (Integrated). Countries: Spain (authorised, recruitment pending), France (not authorised), Denmark (authorised, recruitment pending), Ireland (authorised, recruitment pending), Germany (authorised, recruitment pending).
Therapeutic area(s): Diseases [C] - Nervous System Diseases [C10]
Gender: Female, Male. Age: 0-17 years, 18-64 years. Enrolment: 111.
Decision date: 2026-06-30. Results received: No. Last updated: 2026-07-06.
Decision dates by country: DK: 2026-06-30, FR: 2026-06-30, DE: 2026-06-30, IE: 2026-07-03, ES: 2026-07-06

Condition(s): Participants with relapsed HRNB and participants with HRNB refractory to treatment; The clinical trial will recruit participants aged ≥18 months to <18 years, and therefore all participants will be minors at the time of consent.
Product: Temodal 5 mg hard capsules, Daretabart, IRINOTECAN

Primary endpoint: Primary efficacy endpoint defined in Sub Protocol, Sub Protocol A: ORR defined as the proportion of participants treated with hu14.18K322A in combination with chemotherapy who achieve a CR or PR according to the INRC Sub Protocol B: mCRR defined as the proportion of participants treated with hu14.18K322A in combination with chemotherapy who achieve an overall mCR response
Endpoint(s): Multiple secondary endpoints as described in Protocol Section M.2, A2 and B2.

Source: https://euclinicaltrials.eu/ctis-public/view/2025-524397-42-00